EU clinical trial 2023-506886-76-00: Standard dosed alectinib versus Therageutic Drug Monitoring guided alectinib dosing: The Adapt Alec trial
Protocol code: NL77596.042.21
Sponsor: Universitair Medisch Centrum Groningen (Hospital/Clinic/Other health care facility). Phase: Therapeutic use (Phase IV). Countries: Netherlands (ongoing, recruiting), France (authorised, recruiting).
Therapeutic area(s): Diseases [C] - Respiratory Tract Diseases [C08]; Diseases [C] - Neoplasms [C04]
Gender: Female, Male. Age: 18-64 years, 65+ years. Enrolment: 196.
Start date (EU): 2022-03-23. Decision date: 2024-01-29. Results received: No. Last updated: 2025-04-02.
Decision dates by country: FR: 2024-10-31, NL: 2024-01-29

Condition(s): ALK positive non-small cell lung cancer
Product: Alecensa 150 mg hard capsules

Primary endpoint: The main endpoint will be an increase in progression free survival (PFS according to RECIST v1.1) in the subgroups of patients with an alectinib Cmin treshhold <435 ng/mL in the TDM-guided dosing cohort versus the same subgroup in the fixed dosing cohort
Endpoint(s): Feasibility and safety of TDM. This will be measured as percentage of successful TDM measures, in which successful is defined as target attainment with manageable toxicity., Physician adherence to TDM advice. This will be measured as the percentage of dose recommendations that are implemented by the treating physicians., Overall response rates (ORR). ORR will be defined as partial response or complete response (according to RECIST v1.1) percentage of the total treated population., Median overall survival (mOS). OS will be defined as the time from randomization to death from any cause in the total population. Patients who do not die or are lost to follow-up will be censored at their last available date., Intracranial PFS. The intracranial PFS will be measured as time from start of treatment to progressive disease in the brain, or death from any cause. Patients who did not die or progress, or lost to follow-up, will be censored at their last available date., Patient adherence. This will be estimated by pill counts of returned medication as well as a patient diary on drug intake., Toxicity related to the plasma concentration and dose increases. This will be defined as AE’s in the subgroups with Cmin < 435 ng/mL and all Cmin ≥ 435 ng/mL, and in patients who did and who did not receive a PK-guided dose increase., Quality of life (QoL). This will be determined using the EORTC QLQ_LC13 as addition to the QLQ-C30 questionnaire, and the EQ-5D-5L questionnaire., Cost-effectiveness. This will be determined by the incremental cost-effectiveness ratio based on costs and quality adjusted life-years (QALYs), Alectinib-M4 concentrations. These will be measured in the alectinib plasma samples.

Source: https://euclinicaltrials.eu/ctis-public/view/2023-506886-76-00